EU clinical trial 2024-514183-21-00: VERDICT: In actiVE ulcerative colitis, a RanDomIzed Controlled Trial for determination of the optimal treatment target
Protocol code: RP1706
Sponsor: Alimentiv Inc. (Pharmaceutical company). Phase: Therapeutic use (Phase IV). Countries: Italy (ended), Belgium (ended), France (ended), Netherlands (ended), Poland (ended).
Therapeutic area(s): Diseases [C] - Digestive System Diseases [C06]
Gender: Female, Male. Age: 18-64 years, 65+ years. Enrolment: 391.
Status: Ended. Start date (EU): 2021-01-15. End date (EU): 2026-04-02. End date: 2026-04-03. Decision date: 2024-09-12. Results received: No. Last updated: 2025-08-19.
Decision dates by country: BE: 2024-09-12, FR: 2024-09-13, IT: 2024-09-23, NL: 2024-09-13, PL: 2024-09-30

Condition(s): Ulcerative colitis
Product: Entyvio 108 mg solution for injection in pre-filled syringe, Entyvio 300 mg powder for concentrate for solution for infusion

Primary endpoint: The primary efficacy evaluation is time to UC-related complication according to the achieved-target population, defined by the subset who met their assigned treatment targets.
Endpoint(s): Time to UC-related complication in the full analysis set, including subgroups on and off corticosteroids at the time of achieving other relevant components of the treatment target, Whether treatment to the target of symptomatic + endoscopic remission (Group 2) is superior to a treatment target of symptomatic remission (Group 1) in terms of the primary endpoint (both in the full and the achieved-target populations), Whether treatment to the target of corticosteroid-free symptomatic + endoscopic + histological remission (Group 3) is superior to a treatment target of corticosteroid-free symptomatic + endoscopic remission (Group 2) in terms of the primary endpoint (both in the full and the achieved-target populations), Time to UC-related complication (as in the primary outcome and secondary outcomes 2 and 3) in the subgroup of subjects who exclusively reach their assigned target and not a higher target by Week 48, Time taken to achieve the respective targets in each group. Time will be censored for subjects who do not achieve their assigned target by Week 48, Across the 3 randomized groups, time to each type of UC-related complication separately that comprises the primary endpoint (both in the full and the achieved-target populations), The effect of treatment(s) on UC-related complications that is mediated through treatment targets, Change in fecal calprotectin levels from baseline to Weeks 8, 16, 32, 48, and 96 (both in the full and the achieved-target populations), Change in C-reactive protein (CRP) concentration from baseline to Weeks 8, 16, 32, 48, 64, 80, and 96 (both in the full and the achieved-target populations), Change in the UC-100 score from baseline to Weeks 16, 32, 48, and 96 (both in the full and the achieved-target populations), Change in health-related quality of life (HRQoL) using the Inflammatory Bowel Disease Questionnaire (IBDQ) from baseline to Weeks 16, 32, 48, 64, 80, and 96 (both in the full and the achieved-target populations), Change in the Work Productivity and Activity Impairment-UC (WPAI-UC) questionnaire from baseline to Weeks 16, 32, 48, 64, 80, and 96 (both in the full and the achieved-target populations), Change in Mayo Clinic Score (MCS; and subcomponents including the MES) from baseline to Weeks 16, 32, 48, and 96 (both in the full and the achieved-target populations), Change in Geboes score from baseline to Weeks 16, 32, 48, and 96 (both in the full and the achieved-target populations), Change in Robarts Histopathology Index (RHI) scores from baseline to Weeks 16, 32, 48, and 96 (both in the full and the achieved-target populations), Change in Nancy Histological Index scores from baseline to Weeks 16, 32, 48, and 96 (both in the full and the achieved-target populations), The numbers of adverse events (AEs) and serious AEs among the 3 randomized groups, Evaluation of urine, stool, colonic mucosa, and serum samples for biomarkers and drug concentrations that are associated with clinically important outcomes, Validation of the Symptoms and Impacts Questionnaire for UC (SIQ-UC) tool in English-fluent subjects

Source: https://euclinicaltrials.eu/ctis-public/view/2024-514183-21-00